EU clinical trial 2024-514318-11-00: Pharmacokinetics of inhaled levosimendan: a pilot study
Sponsor: UZ Brussel (Hospital/Clinic/Other health care facility). Phase: Human Pharmacology (Phase I)- Bioequivalence Study. Countries: Belgium (ended).
Therapeutic area(s): Diseases [C] - Cardiovascular Diseases [C14]
Gender: Female, Male. Age: 18-64 years, 65+ years. Enrolment: 6.
Status: Ended. Start date (EU): 2024-01-17. End date (EU): 2025-12-24. Decision date: 2024-09-12. Results received: No. Last updated: 2026-01-26.

Condition(s): heart failure

Source: https://euclinicaltrials.eu/ctis-public/view/2024-514318-11-00